EU clinical trial 2024-520426-11-00: An open-label, non-randomized, single dose, phase II trial of FG001 (an optical imaging agent) for localization of Meningiomas or presumed Low- Grade Gliomas scheduled for neurosurgery.
Protocol code: RH-FG001-001
Sponsor: Copenhagen University Hospital (Hospital/Clinic/Other health care facility). Phase: Therapeutic exploratory (Phase II). Countries: Denmark (authorised, recruitment pending).
Therapeutic area(s): Diseases [C] - Neoplasms [C04]
Gender: Female, Male. Age: 18-64 years, 65+ years. Enrolment: 40.
Status: Authorised, recruitment pending. Decision date: 2025-01-29. Results received: No. Last updated: 2026-03-31.

Condition(s): Glioma, Meningioma
Product: FG001

Primary endpoint: Sensitivity detection of tumor tissue in meningioma with its dural attachment, and pLGG using histology as a reference.
Endpoint(s): Efficacy (Demonstrate exposure of FG001), Safety and tolerability (Adverse Events, laboratory parameters, 12 - lead ECG parameters, vital signs)

Source: https://euclinicaltrials.eu/ctis-public/view/2024-520426-11-00